EU clinical trial 2025-521650-42-00: "A study in healthy people to test how 2 different formulations of a combination treatment (vicadrostat and empagliflozin) are taken up in the body and how food influences the amount of the medicines in the blood"
Protocol code: 1378-0043
Sponsor: Boehringer Ingelheim International GmbH (Pharmaceutical company). Phase: Human Pharmacology (Phase I)- Other. Countries: Germany (ended).
Therapeutic area(s): Not possible to specify
Gender: Female, Male. Age: 18-64 years. Enrolment: 40.
Status: Ended. Start date (EU): 2025-09-04. End date (EU): 2025-10-22. Decision date: 2025-07-23. Results received: No. Last updated: 2025-09-01.

Condition(s): Healthy volunteer trial

Source: https://euclinicaltrials.eu/ctis-public/view/2025-521650-42-00